EU clinical trial 2022-503007-22-00: A Randomized, Double-Blind, Phase II Study of BMS-986315 and Nivolumab in Combination with Chemotherapy Versus Nivolumab in Combination with Chemotherapy as First-line Treatment for Participants with Stage IV or Recurrent Non-Small Cell Lung Cancer (NSCLC)
Protocol code: CA0471009
Sponsor: Bristol-Myers Squibb Services Unlimited Company (Pharmaceutical company). Phase: Therapeutic exploratory (Phase II). Countries: Spain (ended), Romania (ended), Italy (ended), Poland (ended), France (ended).
Therapeutic area(s): Diseases [C] - Neoplasms [C04]
Gender: Female, Male. Age: 18-64 years, 65+ years. Enrolment: 95.
Status: Ended. End date (EU): 2024-02-29. End date: 2024-08-08. Decision date: 2024-01-22. Results received: Yes. Last updated: 2024-02-01.
Decision dates by country: RO: 2024-01-29, ES: 2024-01-29, PL: 2024-01-26, FR: 2024-01-22, IT: 2024-01-25

Condition(s): Non-small Cell Lung Cancer
Product: CISPLATIN, OPDIVO 10 mg/mL concentrate for solution for infusion., PACLITAXEL, anti-NKG2A mAb, CARBOPLATIN, PEMETREXED DISODIUM

Primary endpoint: Part 1: Main endpoints include incidence of all adverse events (AEs), including AEs leading to discontinuation, and death (per CTCAE v5.0)., Part 2: Main endpoint is the Objective Response Rate (ORR) assessed by BICR (a blinded independent central review committee).
Endpoint(s): Part 2: Secondary endpoints include summary measures of BMS-986315 PK parameters and additional anti-tumor efficacy parameters, such as PFS, by BICR.

Source: https://euclinicaltrials.eu/ctis-public/view/2022-503007-22-00